EU clinical trial 2022-502390-41-00: A safety study of PF-08046045/SGN-35T in adults with advanced cancers
Protocol code: C5811001/ SGN35T-001
Sponsor: Seagen Inc. (Pharmaceutical company). Phase: Human Pharmacology (Phase I)- First administration to humans. Countries: Germany (ended), Spain (ended), Denmark (ended), Italy (ended).
Therapeutic area(s): Diseases [C] - Hemic and Lymphatic Diseases [C15]; Diseases [C] - Neoplasms [C04]
Gender: Female, Male. Age: 18-64 years, 65+ years. Enrolment: 35.
Status: Ended. Start date (EU): 2024-06-20. End date (EU): 2025-07-15. End date: 2025-12-10. Decision date: 2024-04-29. Results received: No. Last updated: 2025-08-11.
Decision dates by country: DK: 2024-04-30, DE: 2024-05-06, ES: 2024-05-06, IT: 2024-04-29

Condition(s): Enteropathy-Associated T-Cell Lymphoma, Cutaneous T-Cell Lymphoma, Non-Hodgkin’s Lymphoma, Angioimmunoblastic T-Cell Lymphoma, Primary Mediastinal large B-Cell Lymphoma, Hodgkin’s Disease, B-Cell Lymphoma, Diffuse Large B-Cell Lymphoma, Anaplastic Large-Cell Lymphoma T- and Null-Cell Types, Peripheral T-Cell Lymphoma unspecified

Source: https://euclinicaltrials.eu/ctis-public/view/2022-502390-41-00